EU clinical trial 2023-508213-16-00: A Phase 2, Randomized, Parallel, Open-Label Study to Investigate the Safety, Efficacy, and Pharmacokinetics of Various Dosing Regimens of Single-Agent Belantamab Mafodotin (GSK2857916) in Participants with Relapsed or Refractory Multiple Myeloma (DREAMM-14)
Protocol code: 209628
Sponsor: Glaxosmithkline Research & Development Limited (Pharmaceutical company). Phase: Therapeutic exploratory (Phase II). Countries: Spain (ended), Poland (ended), Italy (ended), Germany (ended), Ireland (ended), Greece (ended), France (ended).
Therapeutic area(s): Diseases [C] - Neoplasms [C04]
Gender: Female, Male. Age: 18-64 years, 65+ years. Enrolment: 60.
Status: Ended. Start date (EU): 2022-03-15. End date (EU): 2026-02-05. End date: 2026-02-10. Decision date: 2024-03-11. Results received: No. Last updated: 2025-10-10.
Decision dates by country: DE: 2024-03-13, FR: 2024-03-22, IE: 2024-03-11, ES: 2024-03-15, IT: 2024-03-14, GR: 2024-04-22, PL: 2024-03-25

Condition(s): Multiple Myeloma

Primary endpoint: Incidence rate of Grade ≥2 corneal events according to the KVA scale
Endpoint(s): Cumulative event rate of corneal events to Week 16 (KVA scale), Incidence rate of corneal events by grade (KVA scale), Exposure-adjusted incidence rate of corneal events by grade (KVA scale), Median duration of dose delay, Percentage of participants requiring dose reductions, dose delays, and study treatment discontinuation due to corneal events (KVA scale), Cumulative incidence of corneal events by grade (KVA scale), Toxicity Index by assessment/visit, Percentage of time on study with corneal events (KVA scale), Change in BCVA (ΔlogMAR), ORR, defined as the percentage of participants with a confirmed PR or better (i.e., PR, VGPR, CR, and sCR), Percentage of participants with a confirmed VGPR or better (i.e., VGPR, CR, and sCR), TTR is defined as the time between the date of randomization and the first documented evidence of response (PR or better), among participants who achieve a response (i.e., confirmed PR or better), DoR in responders, defined as the time from first documented evidence of PR or better until PD or death due to any cause, TTP, defined as the time from randomization until the earliest date of documented PD or death due to PD, PFS, defined as the time from randomization until the earliest date of documented PD or death due to any cause, OS, defined as the time from randomization until the date of death due to any cause, Instance of AEs (including ocular AEs) (CTCAE Version 5.0) and changes in laboratory parameters, Percentage of participants requiring dose reductions, dose delays, and study treatment discontinuation due to any AEs (CTCAE Version 5.0), Plasma belantamab mafodotin pharmacokinetic parameters, as data permit, Incidence and titers of ADAs against belantamab mafodotin at each ADA time point

Source: https://euclinicaltrials.eu/ctis-public/view/2023-508213-16-00